EU clinical trial 2024-511866-36-00: Piperacillin-tazobactam and temocillin as carbapenem-alternatives for the treatment of severe infections due to extended-spectrum beta-lactamase–producing Gram-negative Enterobacteriaceae in the intensive care unit (PITAGORE)
Protocol code: APHP211034
Sponsor: Assistance Publique Hopitaux De Paris (Hospital/Clinic/Other health care facility). Phase: Therapeutic confirmatory (Phase III). Countries: France (ongoing, recruiting).
Therapeutic area(s): Diseases [C] - Virus Diseases [C02]
Gender: Female, Male. Age: 18-64 years, 65+ years. Enrolment: 600.
Status: Ongoing, recruiting. Start date (EU): 2023-03-11. Decision date: 2024-09-27. Results received: No. Last updated: 2026-06-09.

Condition(s): patients hospitalized in ICU with ESBL-producing Enterobacteriaceae severe infection
Product: MEROPENEM ARROW 1 g, poudre pour solution injectable / pour perfusion, PIPERACILLIN AND BETA-LACTAMASE INHIBITOR, NEGABAN 2 g, poudre pour solution injectable/pour perfusion

Primary endpoint: Mortality at 30 days from the date of randomization
Endpoint(s): 90-day mortality rate., Relapse rates of ESBL infection at day 30., Clinical failure rate at day 30 (relapse of ESBL infection or death between randomization and day 30)., Rate of antibiotic allergy at day 30., Rate of adverse events at day 30,, ICU length of stay, Hospital length of stay, ICU-free days at day 30, Hospital-free days at day 30, Antibiotic-free days at day 30, Kinetics of organ failure from randomization to day 30 post-randomization, assessed by the sequential organ failure assessment (SOFA) score and its components, Rate of faecal colonization with carbapenem-resistant Gram-negative bacilli at end of treatment, ICU discharge and day 90, Rate of Clostridium difficile infection at day 90., Rate of secondary nosocomial infection at day 90, Proportion of patients in whom duration of antimicrobial treatment of the index episode (the episode that led to inclusion in the study) has been exceeded compared to the recommended duration., Proportion of patients who change their treatment before the recommended duration without relapse (= cross-over)

Source: https://euclinicaltrials.eu/ctis-public/view/2024-511866-36-00